EU clinical trial 2024-511468-94-00: A study to learn how safe KER-0193 is, the activity of KER-0193 in the body over a period of time, and the effect of KER-0193 to the body in adult healthy people taking single and multiple doses by the mouth that are increased a little at a time
Sponsor: Kaerus Bioscience Limited (Pharmaceutical company). Phase: Human Pharmacology (Phase I)- First administration to humans. Countries: Belgium (ended).
Therapeutic area(s): Diseases [C] - Congenital, Hereditary, and Neonatal Diseases and Abnormalities [C16]
Gender: Female, Male. Age: 18-64 years. Enrolment: 80.
Status: Ended. Start date (EU): 2024-07-10. End date (EU): 2024-12-26. Decision date: 2024-06-14. Results received: No. Last updated: 2024-07-10.

Condition(s): Fragile X syndrome

Source: https://euclinicaltrials.eu/ctis-public/view/2024-511468-94-00